EU clinical trial 2023-510434-83-00: Sustained treatment-free remission in BCR-ABL+ chronic myeloid leukemia: a prospective study comparing Nilotinib versus Imatinib with switch to Nilotinib in absence of optimal response. SUSTRENIM Study – GIMEMA CML1415
Protocol code: CML1415 - Sustrenim
Sponsor: Fondazione Gimema Franco Mandelli Onlus (Patient organisation/association). Phase: Therapeutic use (Phase IV). Countries: Netherlands (ended), Italy (ended).
Therapeutic area(s): Diseases [C] - Hemic and Lymphatic Diseases [C15]
Gender: Female, Male. Age: 18-64 years, 65+ years. Enrolment: 450.
Status: Ended. Start date (EU): 2016-10-17. End date (EU): 2026-05-05. Decision date: 2024-07-08. Results received: No. Last updated: 2025-04-11.
Decision dates by country: NL: 2024-07-08, IT: 2024-07-15

Condition(s): Chronic Myeloid Leukemia (CML) in Chronic Phase (CP)
Product: Glivec 100 mg hard capsules, Tasigna 150 mg hard capsules

Primary endpoint: To evaluate the rates of molecular response (MR4.5) at 24 months, To evaluate the rates of molecular response (MR4.5) at 24 months - To evaluate the rate of patients who remain in sustained treatment free remission (=MR3.0) without molecular relapse 12 months after entering the TFR phase. The molecular relapse is defined as loss of MMR, or confirmed loss of MR3.0
Endpoint(s): To determine the depth of molecular response by 4 years., To estimate progression-free survival (PFS) in the two arms of the study at 60 months, To estimate the Overall Survival in the two arms of the study at 60 months, To determine the rates of major molecular response (MR3.0) at 1, 2, 3, and 4 year in the two arms of the study., The dynamics of molecular response, The relationship between baseline characteristics and the achievement of MR4.5 (after treatment NIL frontline therapy vs IM followed by switch to NIL) and the sustained treatment free remission rate (=MR3.0);, The relationship between early molecular response and the achievement of MR4.5 (after treatment NIL frontline therapy vs IM followed by switch to NIL) and the sustained treatment free remission rate (=MR3.0), To assess the safety profile of either NIL and IM arms, To determine the rate and the time-distribution of the discontinuation of the firstline TKI, for side-effects, toxicity and AEs., To investigate quality of life (QoL) differences between treatment arms over time

Source: https://euclinicaltrials.eu/ctis-public/view/2023-510434-83-00